EU clinical trial 2023-509079-18-00: Evaluation of Safety, Tolerability, and Pharmacodynamic Effects of Topically Applied SUDO-286 in Psoriasis
Protocol code: SUDO-286-101
Sponsor: Sudo Biosciences Limited (Pharmaceutical company). Phase: Human Pharmacology (Phase I)- Other. Countries: Germany (ended).
Therapeutic area(s): Diseases [C] - Skin and Connective Tissue Diseases [C17]
Gender: Female, Male. Age: 18-64 years, 65+ years. Enrolment: 15.
Status: Ended. Start date (EU): 2024-07-22. End date (EU): 2025-04-25. Decision date: 2024-06-24. Results received: No. Last updated: 2025-03-24.

Condition(s): Plaque Psoriasis

Source: https://euclinicaltrials.eu/ctis-public/view/2023-509079-18-00